EU clinical trial 2024-516889-11-00: A Phase 2, Safety and Efficacy Study of PRT3789 in Combination with Pembrolizumab in Patients with Advanced or Metastatic Solid Tumors with a SMARCA4 Mutation
Protocol code: PRT3789-02
Sponsor: Prelude Therapeutics Inc. (Pharmaceutical company). Phase: Therapeutic exploratory (Phase II). Countries: Spain (ended), Germany (ended), France (ended).
Therapeutic area(s): Diseases [C] - Neoplasms [C04]
Gender: Female, Male. Age: 18-64 years, 65+ years. Enrolment: 29.
Status: Ended. Start date (EU): 2025-05-21. End date (EU): 2025-08-14. End date: 2026-01-23. Decision date: 2025-04-16. Results received: Yes. Last updated: 2025-07-29.
Decision dates by country: ES: 2025-04-16, FR: 2025-04-24, DE: 2025-04-16

Condition(s): non-small cell lung cancer (NSCLC), Esophageal Cancer, Advanced or Metastatic Solid Tumors with a SMARCA4 Mutation
Product: KEYTRUDA 25 mg/mL concentrate for solution for infusion, PRT3789

Primary endpoint: Incidence of dose-limiting toxicities, Incidence and severity of adverse events according to the NCI CTCAE v5.0, Objective response rate defined as the proportion of patients with a confirmed best overall response of either complete response or partial response, as determined per investigator assessment by RECIST v1.1, Duration of response defined as the time from the date of the first documented response (complete response or partial response) to the earliest date of disease progression, as determined per investigator assessment by RECIST v1.1, or death due to any cause
Endpoint(s): Objective response rate defined as the proportion of patients with a best overall response of either complete response or partial response, as determined per investigator assessment by RECIST v1.1 (Part 1 only), Duration of response defined as the time from the date of the first documented response (complete response or partial response) to the earliest date of disease progression, as determined per investigator assessment by RECIST v1.1, or death due to any cause (Part 1 only), Clinical benefit response defined as the proportion of patients with a best overall response of complete response, partial response, or durable stable disease (24 weeks or longer), as determined per investigator assessment by RECIST v1.1, PFS defined as the time from the date of first dose of study treatment to the date of first documented progressive disease, as determined per investigator assessment by RECIST v1.1, or death due to any cause, Overall survival defined as the time from the date of first dose of study treatment to death due to any cause, Incidence and severity of adverse events according to the NCI CTCAE v5.0, Changes in clinical laboratory parameters, Incidence of dose interruptions, dose modifications, and discontinuations due to adverse events, The pharmacokinetics of PRT3789 in combination with pembrolizumab including the maximum observed plasma concentration, time of maximum concentration, AUC, steady state trough concentrations, clearance, accumulation, and half-life

Source: https://euclinicaltrials.eu/ctis-public/view/2024-516889-11-00